EU clinical trial 2025-522900-26-00: Tacrolimus as prophylaxis of post-ERCP pancreatitis: a DPSG (Dutch Pancreatitis Study Group) multicenter, double-blind, randomized, placebo-controlled study.
Protocol code: 2025-522900-26-00
Sponsor: Amsterdam UMC Stichting (Patient organisation/association). Phase: Therapeutic use (Phase IV). Countries: Netherlands (authorised, recruitment pending).
Therapeutic area(s): Diseases [C] - Digestive System Diseases [C06]
Gender: Female, Male. Age: 18-64 years, 65+ years. Enrolment: 520.
Status: Authorised, recruitment pending. Decision date: 2026-06-19. Results received: No. Last updated: 2026-06-19.

Condition(s): Post-ERCP Pancreatitis
Product: Prograft 5 mg/ml concentraat voor oplossing voor infusie, sodium chloride 0.9% solution for infusion

Primary endpoint: Occurrence of post-ERCP pancreatitis (PEP) within 48 hours after ERCP, defined according to the revised Atlanta criteria: ≥ 2 of the following: (a) characteristic abdominal pain; (b) serum amylase or lipase > 3× upper limit of normal; (c) imaging findings consistent with pancreatitis.
Endpoint(s): Occurrence of PEP within 30 days after ERCP., Severity of PEP according to the revised Atlanta classification, ERCP-related complications: bleeding, perforation, fever/cholangitis, cholecystitis., Adverse events (AEs), serious adverse events (SAEs), and adverse reactions., Length of hospital or ICU stay; readmissions and additional procedures., Quality of life (EQ-5D-5L) and QALYs up to 12 weeks., Healthcare consumption costs and societal costs as measured with IMCQ and IPCQ questionnaires up to 12 weeks., Tacrolimus whole-blood concentrations (pharmacokinetic cohort, first 40 subjects).

Source: https://euclinicaltrials.eu/ctis-public/view/2025-522900-26-00